EU clinical trial 2024-511610-20-00: A Multicenter, Randomized, Double-Blind, Placebo-Controlled, Parallel Design, Prospective, 52-Week, Phase 2 Clinical Study to Evaluate the Safety and Efficacy of GV1001 Administered Subcutaneously for the Treatment of Mild to Moderate Alzheimer's Disease
Protocol code: GV1001-AD-CL2-007
Sponsor: Gemvax & Kael Co. Ltd. (Pharmaceutical company). Phase: Therapeutic exploratory (Phase II). Countries: Italy (ended), Portugal (ended), Poland (ended), France (ended), Spain (ended), Finland (ended), Netherlands (ended).
Therapeutic area(s): Diseases [C] - Nervous System Diseases [C10]
Gender: Female, Male. Age: 18-64 years, 65+ years. Enrolment: 103.
Status: Ended. Start date (EU): 2022-11-08. End date (EU): 2025-04-16. End date: 2025-04-17. Decision date: 2024-05-06. Results received: Yes. Last updated: 2025-03-26.
Decision dates by country: PT: 2024-06-05, PL: 2024-05-31, ES: 2024-05-13, FR: 2024-05-14, NL: 2024-05-06, IT: 2024-05-29, FI: 2024-05-06

Condition(s): Alzheimer's Disease
Product: GV1001, Solution for injection with no active substance

Primary endpoint: 1. Change from baseline in ADAS-Cog11 score at Week 52, 2. Adverse events (AEs), laboratory test results (hematology, serum chemistry, and urinalysis), ECG findings, and vital signs measurements (pulse rate, blood pressure, respiratory rate, body temperature). Suicidal ideation and behavior will be assessed using the Columbia-Suicide Severity Rating Scale (C-SSRS)
Endpoint(s): Secondary efficacy endpoints: • Clinical worsening, defined as ≥4 points change from baseline in the ADAS-cog11 score at Week 12, Week 26, Week 38, and Week 52, • Change from baseline in A-IADL-Q score at Week 12, Week 26, Week 38 and Week 52, • Change from baseline in NPI score at Week 12, Week 26, Week 38, and Week 52, • Change from baseline in MMSE score at Week 12, Week 26, Week 38, and Week 52, • Change from baseline in CDR-SB score at Week 12, Week 26, Week 38, and Week 52, • Change from baseline in ADCS-CGIC/CIBIC-Plus score at Week 12, Week 26, Week 38, and Week 52, • Change from baseline in QoL-AD score at Week 26 and Week 52

Source: https://euclinicaltrials.eu/ctis-public/view/2024-511610-20-00